EU clinical trial 2024-513644-28-00: Efficacy and safety of Ursodeoxycholic Acid as a new therapy for the treatment of hepatorenal polycystic diseases, genetic study and determination of prognostic biomarkers.
Protocol code: URSOPOL
Sponsor: Asociacion Instituto Biogipuzkoa (Patient organisation/association). Phase: Therapeutic exploratory (Phase II). Countries: Spain (ongoing, recruiting).
Therapeutic area(s): Diseases [C] - Digestive System Diseases [C06]
Gender: Female, Male. Age: 18-64 years, 65+ years. Enrolment: 138.
Status: Ongoing, recruiting. Start date (EU): 2026-06-18. Decision date: 2026-03-02. Results received: No. Last updated: 2026-03-02.

Condition(s): Hepatorenal polycystic diseases
Product: URSODEOXYCHOLIC ACID

Primary endpoint: The primary endpoint is the absolute and percentage change in total liver cyst volume (TLCV) at the beginning and the end of treatment between the two groups.
Endpoint(s): Liver volume: absolute and proportional change in liver volume (TLV/hTLV)., Renal volume: absolute and proportional change in renal volume (TKV/hTKV)., Renal function: glomerular filtration rate (GFR), serum creatinine, indication for dialysis or renal transplantation., Laboratory values: haematology, biochemistry, hormones, coagulation, liver profile (ALT, AST, γGT, ALP, Bi) and CA-19-9., Symptomatology: to be assessed at each visit to the centre using the PLD-Q questionnaire., Quality of life: SF-36 questionnaire., Safety: occurrence of serious adverse events related to the medication and any events occurring during the patient's participation in the trial., Genetic profile: centralized analysis of genes described for the disease., (Exploratory endpoint) - Demographic variables (age, sex)., (Exploratory endpoint) - Medical history., (Exploratory endpoint) -Concomitant medication and adherence to treatment., (Exploratory endopoint) - Physical examination (body weight, height, blood pressure, heart rate)., (Exploratory endopoint) - Kidney cyst volume: absolute and proportional change in renal cyst volume change (TKCV), at the baseline visit, at one year and at the end of treatment., (Exploratory endopoint) - Association analysis between genotype and clinical response to treatment., (Exploratory endopoint) -Treatment response markers based on proteins, RNA, and/or circulating metabolites, among others (liquid biopsy)., (Exploratory endopoint) - Correlation of biomarker levels with: - TLV / hTLV, TLCV and TKV / hTKV and its progression over time, - Clinical response - Liver and kidney function parameters.

Source: https://euclinicaltrials.eu/ctis-public/view/2024-513644-28-00